EU clinical trial 2023-510387-13-00: IFCT-2101 MASTERPROTOCOL ALK A phase II randomized, open-labelled, multicenter study of safety and efficacy of brigatinib and carboplatin-pemetrexed combination therapy or brigatinib monotherapy as first-line treatment in patients with advanced ALK-positive non-small cell lung cancer
Protocol code: IFCT-2101
Sponsor: Intergroupe Francophone De Cancerologie Thoracique (Patient organisation/association). Phase: Therapeutic exploratory (Phase II). Countries: France (ongoing, recruitment ended).
Therapeutic area(s): Diseases [C] - Neoplasms [C04]
Gender: Female, Male. Age: 18-64 years, 65+ years. Enrolment: 110.
Status: Ongoing, recruitment ended. Start date (EU): 2022-05-18. Decision date: 2024-02-21. Results received: No. Last updated: 2025-02-11.

Condition(s): advanced ALK-positive non-small cell lung cancer
Product: CARBOPLATINE HOSPIRA 10 mg/ml, solution injectable pour perfusion, Alunbrig 30 mg film-coated tablets, Alunbrig 180 mg film-coated tablets, Pemetrexed Viatris 25 mg/ml, solution à diluer pour perfusion

Primary endpoint: Progression-Free Survival (PFS) at 12 months as determined by investigator assessment
Endpoint(s): PFS at 12 months as determined by independent review, Confirmed Overall Response Rate (ORR) as determined by investigator assessment and by independent review, Incidence, nature, and severity of adverse events, graded according to the National Cancer Institute Common Terminology Criteria for Adverse Events, Version 5.0 (NCI CTCAE v5.0), PFS at 12 months in sub-populations as determined by investigator assessment and independent review, ORR in sub-populations as determined by investigator assessment and independent review, Confirmed Intracranial ORR as determined by investigator assessment and by independent review, Intracranial PSF at 12 months, Time until definitive HRQoL score deterioration using EORTC QLQC30/ QLQ-LC13 questionnaire, Duration of Response (DOR) as determined by investigator assessment and by independent review, Disease Control Rate (DCR) as determined by investigator assessment and by independent review, Overall Survival (OS), Duration of intracranial response (CNS DOR) as determined by investigator assessment and by independent review, Intracranial DCR as determined by investigator assessment and by independent review

Source: https://euclinicaltrials.eu/ctis-public/view/2023-510387-13-00